EU clinical trial 2022-501099-24-00: A Multicenter, Open-label, Extension Study to Evaluate the Long-term Safety and Tolerability of Atogepant in Pediatric Subjects 6 to 17 years of age with Migraine
Protocol code: M21-199
Sponsor: Abbvie Deutschland GmbH & Co. KG (Pharmaceutical company). Phase: Therapeutic confirmatory (Phase III). Countries: Belgium (ongoing, recruiting), Denmark (ongoing, recruiting), Italy (ongoing, recruiting), Netherlands (ongoing, recruiting), Poland (ongoing, recruiting), Spain (ongoing, recruiting), Hungary (ongoing, recruiting), France (ended), Sweden (ongoing, recruiting), Romania (ended), Portugal (authorised, recruiting).
Therapeutic area(s): Diseases [C] - Nervous System Diseases [C10]
Gender: Female, Male. Age: 0-17 years. Enrolment: 127.
Start date (EU): 2023-12-22. Decision date: 2023-08-21. Results received: No. Last updated: 2026-06-19.
Decision dates by country: RO: 2023-08-28, BE: 2023-08-21, DK: 2023-08-22, FR: 2023-08-25, SE: 2023-08-25, PL: 2023-08-28, ES: 2023-08-24, IT: 2023-08-23, HU: 2023-08-24, NL: 2023-08-25, PT: 2026-05-08

Condition(s): Migraine
Product: Atogepant, Atogepant, Atogepant

Primary endpoint: The endpoints of Study M21-199 are the safety and tolerability of atogepant, including: Adverse event (AE) monitoring for severity and incidence including adverse event of special interests (AESIs), Clinical laboratory testing (hematology, chemistry, and urinalysis), Electrocardiogram (ECG) variables, Vital sign measurements, Treatment-emergent suicidal ideations with intent, with or without a plan (i.e., Type 4 or 5 on Columbia-Suicide Severity Rating Scale [C-SSRS]) or any suicidal behaviors, Menstrual cycle assessments (female subject only), Tanner Stage scale, Behavior Rating Inventory of Executive Function, 2nd Edition (BRIEF2)

Source: https://euclinicaltrials.eu/ctis-public/view/2022-501099-24-00